EU clinical trial 2024-514636-25-00: EDEN : Prospective therapeutic de-escalation and miRNA-M371 biomarker evaluation Phase II study for stage IIa/IIb < 3 cm seminomas
Protocol code: ET21-344
Sponsor: Centre Leon Berard (Hospital/Clinic/Other health care facility). Phase: Therapeutic exploratory (Phase II). Countries: France (ongoing, recruiting).
Therapeutic area(s): Diseases [C] - Neoplasms [C04]
Gender: Female, Male. Age: 18-64 years, 65+ years. Enrolment: 90.
Status: Ongoing, recruiting. Start date (EU): 2023-05-04. Decision date: 2024-11-08. Results received: No. Last updated: 2026-03-23.

Condition(s): Stage IIa/IIb < 3 cm seminoma
Product: ETOPOSIDE, Cisplatin Teva® 1 mg/ml Konzentrat zur Herstellung einer Infusionslösung, CARBOPLATIN

Primary endpoint: the progression-free rate at 36 months (PFR-36m) defined as the proportion of patients with a complete response (CR), a partial response (PR) or a stable disease (SD) at 36 months according to RECIST v1.1. Prevalence of events (relapse or death) is expected to be low
Endpoint(s): - Association between serum level of miRNA-M371 (MiRNA-M371 expression rate measured before the introduction of chemotherapy, before the second cycle of chemotherapy (EP or carboplatin) or before the beginning of radiotherapy and at the end of treatment) and response to treatment (according to RECIST v1.1), - Correlation between serum level of miRNA-M371 and FDG-PET results (complete metabolic response),, - OS, defined as the time from the date of inclusion to the date of death from any cause. Any patient whose death is not known at the time of analysis will be censored based on the last recorded date on which the patient was known to be alive, - QoL, assessed using the EORTC QLQ-C30 (baseline, at the end of treatment visit)., - Safety profile, determined using the NCI-CTC AE grading scale version 5. Adverse events will be described by their intensity and severity.

Source: https://euclinicaltrials.eu/ctis-public/view/2024-514636-25-00